EU clinical trial 2024-519509-37-00: A phase I/II trial of D,L-MEthadone and mFOLFOX6 in treatment of advanced colorectal cancer (MEFOX)
Protocol code: AIO-KRK-0119
Sponsor: AIO-Studien gGmbH (Laboratory/Research/Testing facility). Phase: Phase I and Phase II (Integrated)- Other. Countries: Germany (ended).
Therapeutic area(s): Diseases [C] - Neoplasms [C04]
Gender: Female, Male. Age: 18-64 years, 65+ years. Enrolment: 84.
Status: Ended. Start date (EU): 2025-02-25. End date (EU): 2026-02-28. Decision date: 2024-11-27. Results received: No. Last updated: 2025-10-15.

Condition(s): Patients with advanced, histologically confirmed, metastatic colorectal carcinoma
Product: OXALIPLATIN, FOLINIC ACID, Methasan 10 mg/ml Konzentrat zur Herstellung einer Lösung zum Einnehmen., FLUOROURACIL

Primary endpoint: Phase I: Evaluation of the toxicity-profile of D,L-methadone and the dose-limiting toxicity (DLT) in combination with mFOLFOX6 Estimation of the maximum tolerated dose (MTD) of D,L-methadone hydrochlorid in the combination with mFOLFOX6 Evaluation of the recommended dose for phase-II-trial (RPTD) of D,Lmethadone hydrochlorid, Phase II: Effect of mFOLFOX6 + D,L-methadone compared to mFOLFOX6 alone on disease control rate (DCR) defined as response (CR or PR) or stabilization (SD) of the tumor disease 12 weeks after randomization in ITT-analysis. DCR will be evaluated according to RECIST1.1 in patients with histologically confirmed chemorefractory colorectal carcinoma
Endpoint(s): Disease control rate 12 weeks after randomization (per-protocolpopulation), overall response rate according to RECIST 1.1, patientreported outcomes, PFS, overall survival, quality of life, safety, correlation of μ opioid receptor expression in tumor tissue and efficacy

Source: https://euclinicaltrials.eu/ctis-public/view/2024-519509-37-00